EU clinical trial 2023-506932-33-00: KEYMAKER-U01 Substudy 1: A Phase 2, Umbrella Study with Rolling Arms of Investigational Agents with Pembrolizumab in Combination with Chemotherapy in Treatment-Naive Patients with Advanced Non-small Cell Lung Cancer (NSCLC)
Protocol code: MK-3475-01A
Sponsor: Merck Sharp & Dohme LLC (Pharmaceutical company). Phase: Therapeutic exploratory (Phase II). Countries: Italy (ended), Hungary (ended), Poland (ended), Spain (ended).
Therapeutic area(s): Diseases [C] - Neoplasms [C04]
Gender: Female, Male. Age: 18-64 years, 65+ years. Enrolment: 163.
Status: Ended. Start date (EU): 2020-10-20. End date (EU): 2025-09-18. Decision date: 2024-01-03. Results received: No. Last updated: 2025-11-14.
Decision dates by country: IT: 2024-01-12, HU: 2024-01-03, PL: 2024-01-31, ES: 2024-01-23

Condition(s): non-small cell lung cancer
Product: rolistobart, KEYTRUDA 25 mg/mL concentrate for solution for infusion, PACLITAXEL, CARBOPLATIN, MK-4830, MK-4830, PEMETREXED, boserolimab, vibostolimab

Primary endpoint: Objective Response Rate (ORR) According to Response Evaluation Criteria in Solid Tumors Version 1.1 (RECIST 1.1)
Endpoint(s): Progression-Free Survival (PFS) According to Response Evaluation Criteria in Solid Tumors Version 1.1 (RECIST 1.1), Number of Participants Who Experience One or More Adverse Events (AE), Number of Participants Who Discontinue Treatment Due to an Adverse Event

Source: https://euclinicaltrials.eu/ctis-public/view/2023-506932-33-00